EU clinical trial 2024-514630-21-00: A Randomized Phase II Study to Evaluate the Incidence of Discontinuations due to Diarrhoea at 3 Cycles in patients with Early-stage HER2-positive (HER2+), Hormone Receptor-positive (HR+) Breast Cancer treated with Neratinib plus Loperamide prophylaxis versus Neratinib with Initial Dose Escalation plus PRN Loperamide prophylaxis versus Neratinib plus Loperamide plus Colesevelam prophylaxis. “DIANER Study”
Protocol code: GEICAM/2018-06
Sponsor: Fundacion Grupo Espanol De Investigacion En Cancer De Mama (Patient organisation/association). Phase: Therapeutic exploratory (Phase II). Countries: Spain (ongoing, recruitment ended), Croatia (ongoing, recruitment ended), Italy (ongoing, recruitment ended), France (ongoing, recruitment ended).
Therapeutic area(s): Diseases [C] - Neoplasms [C04]
Gender: Female, Male. Age: 18-64 years, 65+ years. Enrolment: 175.
Status: Ongoing, recruitment ended. Start date (EU): 2022-08-11. Decision date: 2024-11-05. Results received: No. Last updated: 2026-06-24.
Decision dates by country: HR: 2024-12-10, FR: 2024-11-18, IT: 2024-11-11, ES: 2024-11-05

Condition(s): HER2 positive (HER2+), Hormone Receptor positive (HR+) Early-stage Breast Cancer.
Product: Sindiar 2 mg cápsulas duras, NERATINIB

Primary endpoint: Incidence of neratinib discontinuations due to diarrhoea at the end of 3 cycles of neratinib treatment.
Endpoint(s): Incidence and time to neratinib discontinuations due to any TEAE., Incidence, cumulative duration and time to first episode of any diarrhoea and grade 3 or higher diarrhoea., Incidence and time to neratinib discontinuation due to any reason., Incidence of hospitalisations due to any reason and diarrhoea., Incidence of TEAEs and SAEs that included AESIs (i.e. hepatic, cardiac, pulmonary, reproductive and developmental)., Incidence of Neratinib dose modifications (reductions and dose holds), and dose intensity., FACT B and EQ5D-5L questionnaires.

Source: https://euclinicaltrials.eu/ctis-public/view/2024-514630-21-00